EU clinical trial 2024-516922-70-00: Adoptive therapy with TCR gene-engineered T cells to treat patients with MAGE-C2-positive melanoma and head and neck cancer
Sponsor: Erasmus Universitair Medisch Centrum Rotterdam (Erasmus MC) (Hospital/Clinic/Other health care facility). Phase: Phase I and Phase II (Integrated)- Other. Countries: Netherlands (ongoing, recruiting).
Therapeutic area(s): Diseases [C] - Skin and Connective Tissue Diseases [C17]; Phenomena and Processes [G] - Cell Physiological Phenomena [G04]
Gender: Female, Male. Age: 18-64 years, 65+ years. Enrolment: 20.
Status: Ongoing, recruiting. Start date (EU): 2024-11-29. Decision date: 2024-11-29. Results received: No. Last updated: 2026-03-31.

Condition(s): advanced melanoma or HNSCC
Product: Gamma-retroviral vector MP71 MC2 TCR16-3D9

Primary endpoint: Phase I: AEs according to CTCAE 5.0, Phase I: Recommended Phase II dose, Phase I: Feasibility to deliver this sequence of treatmen, Phase II: Objective response rate according to RECIST v1 .1, Phase II: PFS, Phase II: OS
Endpoint(s): Phase I and II: Persistence and function of MC2-specific T cells in peripheral blood., Phase I and II: Systemic release of inflammatory cytokines after administration of autologous MC2 TCR T cells, Phase I and II: Immune parameters, in particular T cell parameters, in blood and tumor tissues (when available) prior to and during treatmen, Phase I and II: Global DNA hypomethylation and histone acetylation in PBMCs after epigenetic treatment and administration of autologous MC2 TCR T cells

Source: https://euclinicaltrials.eu/ctis-public/view/2024-516922-70-00